EU clinical trial 2023-504760-42-00: An open label, randomized, three-period, three-sequence, crossover bioavailability study to assess the pharmacokinetic and safety profile of Valacyclovir Oral Suspension compared to Valtrex® extemporaneous suspension in normal, healthy subjects under fasting conditions and to investigate the effect of food on the bioavailability of Valacyclovir Oral Suspension.
Sponsor: Dermax (Pharmaceutical company). Phase: Human Pharmacology (Phase I)- Bioequivalence Study. Countries: Czechia (ended).
Therapeutic area(s): Diseases [C] - Skin and Connective Tissue Diseases [C17]; Diseases [C] - Virus Diseases [C02]
Gender: Female, Male. Age: 18-64 years. Enrolment: 30.
Status: Ended. Start date (EU): 2023-09-27. End date (EU): 2023-11-03. Decision date: 2023-07-20. Results received: Yes. Last updated: 2023-12-07.

Condition(s): Not applicable (submitted trial is a bioequivalence study in healthy subjects)
Product: VALTREX, Valacyclovir Powder for Oral Suspension

Primary endpoint: Pharmacokinetic Parameters Evaluated: AUC(0-t), AUC(0-∞), Cmax, tmax, λz , t1/2, and AUCres for valacyclovir and acyclovir in each treatment, Primary Parameters for Bioequivalence Assessment: AUC (0-t), AUC (0-∞), and Cmax for valacyclovir

Source: https://euclinicaltrials.eu/ctis-public/view/2023-504760-42-00